EU clinical trial 2025-524501-32-02: The effect of Broncho-Vaxom on the COPD exacerbations in terms of lung function, lung mechanics, immune state, body composition, quality of life and physical activity.
Sponsor: Semmelweis University, University Of Pecs (Educational Institution). Phase: Therapeutic use (Phase IV). Countries: Hungary (authorised, recruitment pending).
Therapeutic area(s): Diseases [C] - Respiratory Tract Diseases [C08]
Gender: Female, Male. Age: 18-64 years, 65+ years. Enrolment: 260.
Status: Authorised, recruitment pending. Decision date: 2026-03-13. Results received: No. Last updated: 2026-03-13.

Condition(s): COPD exacerbation
Product: Broncho-Vaxom OM kemény kapszula felnőtteknek, Powder without active ingredient.

Primary endpoint: Reduction of the number of moderate (to be treated at home) and severe (hospital) exacerbations at 12 months.
Endpoint(s): • Reduction of RTIs (patient-reported) • Adverse Event (AE) • Study discontinuation due to AEs, • Assessment if COPD exacerbations were triggered by RTIs, • Improvement in 6MWD compared at baseline and end of study, • Improvement of dyspnoe compared at baseline and end of study mMRC scale results., • Reduction of COPD associated symptoms by Broncho-Vaxom • body plethysmography • diffusion capacity test (FEV 1, FVC, FEV 1/FVC, TLC, VC, FRC, RV, DL, CO) • Omron BF511 (mainly fat-free body mass) • CAT-COPD Assessment Test • CCQ-Chronic COPD Questionnaire

Source: https://euclinicaltrials.eu/ctis-public/view/2025-524501-32-02